EU clinical trial 2023-505495-30-00: A Randomized, Multicenter, Double-blind, Parallel-group, Active-control Study of the Efficacy and Safety of Sparsentan for the Treatment of Immunoglobulin A Nephropathy (PROTECT)
Protocol code: 021IGAN17001
Sponsor: Travere Therapeutics Inc. (Pharmaceutical company). Phase: Therapeutic confirmatory (Phase III). Countries: Poland (ongoing, recruitment ended), Portugal (ended), Belgium (ended), France (ongoing, recruitment ended), Germany (ended), Lithuania (ongoing, recruitment ended), Czechia (ended), Italy (ongoing, recruitment ended), Croatia (ended), Estonia (ended), Spain (ongoing, recruitment ended).
Therapeutic area(s): Diseases [C] - Pathological Conditions, Signs and Symptoms [C23]
Gender: Female, Male. Age: 18-64 years, 65+ years. Enrolment: 162.
Start date (EU): 2019-02-01. Decision date: 2024-08-26. Results received: No. Last updated: 2026-04-08.
Decision dates by country: HR: 2024-08-27, DE: 2024-08-28, PT: 2024-08-28, CZ: 2024-08-30, IT: 2024-09-17, BE: 2024-08-28, EE: 2024-09-02, LT: 2024-09-06, PL: 2024-08-30, FR: 2024-08-29, ES: 2024-08-26

Condition(s): Immunoglobulin A Nephropathy (IgAN)
Product: IRBESARTAN, DAPAGLIFLOZIN, Sparsentan_DF3, Sparsentan_DF2

Primary endpoint: Efficacy End points: The primary efficacy endpoint is the change from baseline in the urine protein/creatinine ratio (UP/C) at Week 36., Safety End points: Descriptive statistics will be used to summarize the safety data. All safety evaluations will be conducted based on the Safety Analysis Set. Observed data will be listed by patient., Open-Label Extension Period: Endpoints for the open-label extension period include, but are not necessarily limited to: The absolute and percent change from Week 114 in eGFR at each visit, Open-Label Extension Period: The percent change from Week 114 in UP/C at each visit, Open-Label Extension Period: Changes from Week 114 in QoL at each visit, Open-Label Extension Period: Changes from Week 114 in body weight, vital signs, physical examinations, peripheral edema, and clinical laboratory parameters, Open-Label Extension Period: Changes from Week 114 in lipid profile (total cholesterol and triglycerides, low density lipoprotein C, and high density lipoprotein C), Open-Label Extension Period: The incidence of TEAEs during the open-label extension period, Sparsentan + SGLT2 Inhibitor Sub-study: For the Sub-study, the baseline visit (Day 1) is defined as the visit upon which eligibility is assessed. Safety Endpoints: Safety evaluations include the following: Changes from Sub-study baseline in body weight, vital signs, physical examinations, peripheral edema, and clinical laboratory parameters at each visit., Sparsentan + SGLT2 Inhibitor Sub-study: The incidence of TEAEs during the Sub-study period., Sparsentan + SGLT2 Inhibitor Sub-study: Efficacy Endpoints: Endpoints include, but are not limited to: The mean change from Sub-study baseline in UP/C and UA/C based on a 24-hour urine sample at the next scheduled visit., Sparsentan + SGLT2 Inhibitor Sub-study: Achievement of urinary protein excretion <0.3 g/day at the next scheduled visit., Sparsentan + SGLT2 Inhibitor Sub-study: Change in absolute and percent change from Sub-study baseline in eGFR at the next scheduled visit.
Endpoint(s): Rate of change of eGFR

Source: https://euclinicaltrials.eu/ctis-public/view/2023-505495-30-00